EU clinical trial 2024-517654-10-00: Study of Recombinant Adenovirus AdVince in Patients With Neuroendocrine Neoplasms; Safety and Efficacy (RADNET)
Protocol code: VIRUSNET201401
Sponsor: Uppsala University (Educational Institution). Phase: Human Pharmacology (Phase I)- First administration to humans. Countries: Sweden (ended).
Therapeutic area(s): Diseases [C] - Neoplasms [C04]
Gender: Female, Male. Age: 18-64 years, 65+ years. Enrolment: 20.
Status: Ended. Start date (EU): 2016-03-15. End date (EU): 2025-01-09. Decision date: 2024-10-18. Results received: Yes. Last updated: 2024-10-18.

Condition(s): Neuroendocrine neoplasms (NENs) is a heterogeneous group with varying symptoms, tumor biology and treatment response. NENs may occur in any organ, most commonly they are observed in the gastroenteropancreatic system and lungs. Most NEN patients are diagnosed at advanced stage, 65% of them will die within 5 years. The only curative treatment is surgery with complete resection of the primary tumor. However, more than 50% of patients exhibit metastatic disease, where there is no cure.
Product: AdVince

Primary endpoint: Number of Adverse Events (AE) according to CTCA v 4.03, probably or possibly reated to the study drug, reported from the first study-related procedure until 30 days following the last dose, or local injuries caused by the administration procedure checked at each administration of Advince, Identify Dose Limiting Toxicity (DLT) from first until last injection of Advince, if possible, Changes in laboratory efficacy and safety parameters, biological serum markers and vital signs over time vs baseline values.
Endpoint(s): Tumor size and tumor metabolic activity by: a) Computer tomography (CT) and/or positron emission tomography (PET) and/or magnetic resonance imaging (MRI) before first and after last treatment cycle; b) Hormone level screening (biological markers) from baseline until progressive disease; c) Progression-free survival (PFS) 24 weeks after 4th cycle., Viral replication by adenovirus quantification of in patients’ blood on day 1, 8, 22 and 50; before and 24h after injection, as well as 72h after injection by QRT-PCR., Humoral response by detection of anti-adenovirus neutralizing antibodies at baseline, day 8 and day 50. Cytokine-mediated immune response is determined by cytokine measurement in plasma at baseline, 24h and 72h (optional) following virus injections.

Source: https://euclinicaltrials.eu/ctis-public/view/2024-517654-10-00